EU clinical trial 2023-507787-39-00: A Phase 2b, multicenter, randomized, double-blind study of safety and efficacy of TAK-755 (rADAMTS13) with minimal to no plasma exchange (PEX) in the treatment of immune-mediated thrombotic thrombocytopenic purpura (iTTP)
Protocol code: TAK-755-2001
Sponsor: Takeda Development Center Americas Inc. (Pharmaceutical company). Phase: Therapeutic exploratory (Phase II). Countries: Austria (ended), Poland (ended), Spain (ended), Italy (ended), Greece (ended).
Therapeutic area(s): Diseases [C] - Hemic and Lymphatic Diseases [C15]
Gender: Female, Male. Age: 18-64 years, 65+ years. Enrolment: 21.
Status: Ended. Start date (EU): 2023-04-27. End date (EU): 2026-02-25. End date: 2026-04-16. Decision date: 2024-09-04. Results received: No. Last updated: 2025-11-18.
Decision dates by country: PL: 2024-09-04, AT: 2024-09-08, GR: 2024-09-20, ES: 2024-09-04, IT: 2024-09-09

Condition(s): Immune-mediated thrombotic thrombocytopenic purpura (iTTP)
Product: RECOMBINANT ADAMTS13 (rADAMTS13), RITUXIMAB

Primary endpoint: Incidence of AEs, SAEs, and AESIs after receiving any dose of IP
Endpoint(s): Achievement of clinical response without on-study PEX, Achievement of clinical response with on-study PEX, Time to clinical response, Occurrence of refractoriness, Time to first on-study PEX in participants who achieved clinical response., Number of days of on-study PEX and total volume of plasma administered to achieve clinical response., Occurrence of treatment failure (failure to achieve clinical response or experience iTTP recurrence)., Occurrence of iTTP recurrence (following clinical response), including exacerbation, or relapse, Time to iTTP recurrence (following clinical response), including, exacerbation, or relapse, Occurrence of any one of the following events: clinical recurrence (following clinical response), iTTP-related death, or major thrombotic event from time of first IP administration through study completion., Time to occurrence of any one of the following events: clinical recurrence (following clinical response), iTTP-related death, or major thrombotic event from time of first IP administration through study completion., Organ damage biomarkers change from baseline at (1) clinical response and (2) study completion • LDH • Troponin, Achievement of clinical remission (achievemnt of clinical response and no occurrence for ≥ 30 days)., ADAMTS13 antigen and activity levels resulting from TAK-755 administration in acute and post-acute phases, VWF antigen and activity levels resulting from TAK-755 administration in acute and post-acute phases.

Source: https://euclinicaltrials.eu/ctis-public/view/2023-507787-39-00